EU clinical trial 2024-517133-40-00: Comparison of neurocognitive outcome in two standard regimen for treatment of low-risk medulloblastoma (COGNITO-MB)
Protocol code: COGNITO-MB
Sponsor: GPOH gGmbH (Patient organisation/association). Phase: Therapeutic confirmatory (Phase III). Countries: France (authorised, recruitment pending), Denmark (authorised, recruitment pending), Germany (authorised, recruitment pending), Belgium (authorised, recruitment pending), Netherlands (authorised, recruitment pending).
Therapeutic area(s): Diseases [C] - Neoplasms [C04]
Gender: Female, Male. Age: 0-17 years. Enrolment: 46.
Status: Authorised, recruitment pending. Decision date: 2025-08-26. Results received: No. Last updated: 2026-01-08.
Decision dates by country: DK: 2025-08-26, FR: 2025-08-28, DE: 2025-08-29, BE: 2025-08-26, NL: 2025-08-28

Condition(s): newly diagnosed, non-metastatic, SHH-activated, TP53-wt, non-MYC amplified medulloblastoma
Product: CARBOPLATIN, CYCLOPHOSPHAMIDE, ETOPOSIDE, THIOTEPA, METHOTREXATE, VINCRISTINE, METHOTREXATE, CISPLATIN

Primary endpoint: Full-Scale Intelligence Quotient (IQ) as measured by the Wechsler Pre-school and Primary Scale of Intelligence (WPPSI-IV) administered to those between the ages of 2 years and 6 months to 7 years and 7 months old at 2.5 years after diagnosis (+/- 6 months)
Endpoint(s): Progression-free survival (PFS): time from diagnosis to first re-lapse, first disease pro-gression or death, whichever occurs first. Censored at the time of last contact in patients with-out event, Survival free of radiotherapy and progression (rtPFS): Time from diagnosis to first radiotherapy, first relapse, first disease progression or death, whatever is first. Censored at last contact in patients without event, Overall survival (OS): time from diagnosis to death due to any cause. Censored at the time of last contact in alive patients, Time to first second malignancy: time from diagnosis to first second malignancy. Death for other reasons will be used as competing event. A second malignancy is any malignant tumor disease defined by the International Classification of Childhood Cancer (ICCC)-3. Benign diseases except ICCC-3 included CNS-tumors are not being considered, Toxicity will be defined according to CTCAE Version 5.0, Time to death due to toxicity: time from diagnosis to death re-lated to therapy (as defined by investigator assessment). In or-der to describe the toxic death rate for the regimens under in-vestigation, deaths occurring in patients after relapse are ex-cluded, even if they occur due to toxicity from relapse therapy. Deaths from reasons other than toxicity will be used as a competing event, WPPSI-IV on therapy (all children >2.5 years at diagnosis), and WISC-V at 5 years after diag-nosis (+/- 12 months range allowed; WPPSI-IV if younger than 6;0 years), Subdomain-specific neurocognitive outcome parameters from WPPSI-IV and WISC-V (primary index scales): Verbal Comprehension Index (all children ≥ 2.5 years old), Visual Spatial Index (all children ≥ 2.5 years old), Fluid Reasoning Index (all children ≥ 4.0 years old), Working Memory Index (all children ≥ 2.5 years old), Processing Speed Index (all children 4 years and older), Subdomain-specific neurocognitive outcome parameters from Beery Visual Motor Integration (VMI) Test (all children ≥ 2.0 years old), Subdomain-specific neurocognitive outcome parameters from Purdue Pegboard Test (all children ≥ 5.0 years old), Development and Adaptive Functioning: Adaptive Behavior Assessment System (ABAS, versions II or 3) at diagnosis, 2.5- and 5 years after diagnosis, Quality of Life (QoL): - PedsQL Infant Scale or PedsQL 4.0 parent-report measure at diagnosis, followed by Ped-sQL 4.0 and PedsQL Fatigue Scale at 2.5 and 5 years after diagnosis by Parent- and Self-report, Quality of Life (QoL): - BRIEF-P or BRIEF or BRIEF 2 parent-report measure based on age at 2.5 and 5 years after diagnosis by Parent-report, Quality of Life (QoL): Strengths and Difficulties Questionnaire (SDQ) parent-report at 2.5 and 5 years after diagnosis, Longitudinal development of neurocognitive, QoL and behavioral outcomes to evaluate potential change over time, change in: ABAS (II or 3) between diagnosis, 2.5 years and 5 years, Longitudinal development of neurocognitive, QoL and behavioral outcomes to evaluate potential change over time, change in: WPPSI-IV (including subtests) between baseline and 2.5 years and WISC-V (including subtests) at 5 years, Longitudinal development of neurocognitive, QoL and behavioral outcomes to evaluate potential change over time, change in: PedsQL between diagnosis, 2.5 years and 5 years af-ter diagnosis, Longitudinal development of neurocognitive, QoL and behavioral outcomes to evaluate potential change over time, change in: BRIEF-P or BRIEF or BRIEF-2 between 2.5 years and 5 years after diagnosis, Longitudinal development of neurocognitive, QoL and behavioral outcomes to evaluate potential change over time, change in: SDQ between 2.5 years and 5 years after diagnosis, Ototoxicity: Hearing evaluation according to SIOP Boston Scales and Chang-Scale 2.5 years and 5 years after diagnosis (patients with normal Distortion-Product Otoacoustic Emissions (DPOAE) will be considered as not having hearing loss), Leukoencephalopathy: modified Fazekas scale: 2.5 and 5 years after diagnosis, To compare PFS, rtPFS, OS between epigenetically defined subtypes of SHH-MB as defined by classification based on the Heidelberg brain tumor classifier Version 11 (or higher): Independent variable = subtyp, dependent variables : PFS, rtPFS, and OS, Rate of patients with genetically confirmed basal cell nevus syndrome (BCNS, Gorlin-Syndrome, OMIM: 109400): Defined by central sequencing of relevant genes from germline material

Source: https://euclinicaltrials.eu/ctis-public/view/2024-517133-40-00